EU clinical trial 2023-505675-73-00: A Phase 3, Randomized, Double-blinded, Placebo-controlled, Multicenter Study to Evaluate Efficacy and Safety of ALXN1850 Versus Placebo Administered Subcutaneously in Pediatric (2 to < 12 years of age) Participants with Hypophosphatasia Who Have Not Received Previous Treatment with Asfotase Alfa
Protocol code: ALXN1850-HPP-305
Sponsor: Alexion Pharmaceuticals Inc. (Pharmaceutical company). Phase: Therapeutic confirmatory (Phase III). Countries: Italy (not authorised), Belgium (ongoing, recruitment ended), Spain (ongoing, recruitment ended), France (not authorised), Poland (ongoing, recruitment ended), Sweden (ongoing, recruitment ended), Finland (ongoing, recruitment ended), Romania (ongoing, recruitment ended).
Therapeutic area(s): Diseases [C] - Congenital, Hereditary, and Neonatal Diseases and Abnormalities [C16]; Diseases [C] - Skin and Connective Tissue Diseases [C17]
Gender: Female, Male. Age: 0-17 years. Enrolment: 13.
Start date (EU): 2024-04-26. Decision date: 2024-02-26. Results received: No. Last updated: 2026-06-02.
Decision dates by country: FR: 2024-03-04, IT: 2024-02-27, BE: 2024-02-26, ES: 2024-04-24, PL: 2024-12-09, FI: 2025-02-27, RO: 2025-02-18, SE: 2024-11-07

Condition(s): hypophosphatasia
Product: ALXN1850, ALXN1850 placebo product

Primary endpoint: RGI-C score at the end of the Randomized Evaluation Period (Day 169)
Endpoint(s): Change from baseline in RSS at the end of the Randomized Evaluation Period (Day 169), "Change from baseline at the end of the Randomized Evaluation Period (Day 169) in the following: - 6MWT (≥ 5 years of age) - % Predicted 6MWT (≥ 5 years of age) - BOT-2 (≥ 4 years of age) - PDMS-3 (< 4 years of age)", RGI-C responder at the end of the Randomized Evaluation Period (Day 169), Change from baseline at the end of the Randomized Evaluation Period (Day 169) in the following: - EQ-5D-Y health state score (≥ 8 years of age) - EQ-5D-Y-Proxy Version 1 health state score (≥ 4 to < 8 years of age) - PODCI-Parent global function score - APPT score (≥ 8 years of age) - Pediatric FACIT-Fatigue score (≥ 8 years of age) -Pediatric FACIT-Fatigue Proxy score (≥ 2 to < 8 years of age), TSQM-9 score at the end of the Randomized Evaluation Period (Day 169), Incidence of TEAEs, TESAEs, AESIs, and AEs leading to study intervention discontinuation or interruption, "Estimation of PK parameters and accumulation ratios - ALXN1850 PK: AUC(0-24h) at Day 1, AUC(0-24h) and C(trough) at D85; accumulation ratio of D85 to Day 1 based on AUC(0-24h)", Plasma ALXN1850 C(trough) over time through the end of the Randomized Evaluation Period (Day 169), "Estimation of PD parameters - Observed, change, and percent changes in plasma concentration of PPi, PLP, PA, and PLP/PL ratio from baseline through the end of the Randomized Evaluation Period (Day 169)", ADA incidence, ADA response categories, and ADA titer, as well as NAb incidence and NAb titers

Source: https://euclinicaltrials.eu/ctis-public/view/2023-505675-73-00